EU clinical trial 2022-502774-17-00: A Phase I/IIa Open-label Dose Escalation and Expansion Study to Evaluate the Safety, Pharmacokinetics, Pharmacodynamics, and Efficacy of AZD7789, an anti-PD-1 and anti-TIM-3 Bispecific Antibody, in Participants with Advanced or Metastatic Solid Tumors
Protocol code: D9570C00001
Sponsor: AstraZeneca AB (Pharmaceutical company). Phase: Phase I and Phase II (Integrated)- First administration to humans. Countries: Spain (ended), Netherlands (ended), France (ended).
Therapeutic area(s): Diseases [C] - Neoplasms [C04]
Gender: Female, Male. Age: 18-64 years, 65+ years. Enrolment: 95.
Status: Ended. Start date (EU): 2021-10-04. End date (EU): 2025-02-27. End date: 2026-07-21. Decision date: 2024-05-31. Results received: Yes. Last updated: 2025-02-17.
Decision dates by country: NL: 2024-06-03, ES: 2024-05-31, FR: 2024-06-04

Condition(s): Advanced or metastatic gastric and gastro-esophageal junction (GEJ) adenocarcinoma, Advanced or Metastatic Non-small Cell Lung Carcinoma, Advanced or Metastatic Solid Tumors
Product: AZD7789

Primary endpoint: Adverse Events (AEs), imAEs, Serious Adverse Events (SAEs), and DLTs, AEs leading to discontinuation of AZD7789, Clinically significant alterations in vital signs, laboratory parameters, and ECG results, Part B Dose Expansion: Objective Response Rate (ORR) according to RECIST v1.1
Endpoint(s): For Dose Escalation: o ORR, Disease Control Rate (DCR), Duration of Response (DoR), and Progression-free Survival (PFS) according to RECIST v1.1, changes in ctDNA and Overall Survival (OS), For Dose Expansion: o DCR, DoR, PFS according to RECIST v1.1, changes in ctDNA and OS, For Dose Escalation and Expansion: o PK parameters including Cmax, AUC, clearance, and t 1/2, For Dose Escalation and Expansion: o Incidence of ADAs against AZD7789 in serum

Source: https://euclinicaltrials.eu/ctis-public/view/2022-502774-17-00